EU clinical trial 2024-519986-23-00: Reduced post-transplant cyclophosphamide dose in patients undergoing haploidentical hematopoietic stem cell transplantation for hematological malignancies: a phase III randomized study (REDUCy)
Sponsor: Assistance Publique Hopitaux De Paris (Hospital/Clinic/Other health care facility). Phase: Therapeutic confirmatory (Phase III). Countries: France (authorised, recruitment pending).
Therapeutic area(s): Diseases [C] - Hemic and Lymphatic Diseases [C15]
Gender: Female, Male. Age: 18-64 years, 65+ years. Enrolment: 180.
Status: Authorised, recruitment pending. Decision date: 2025-07-11. Results received: No. Last updated: 2025-07-11.

Condition(s): The study will involve adult women and men from 16 French centers who have hematological malignancies and are candidates for haploidentical HSCT
Product: CYCLOPHOSPHAMIDE

Primary endpoint: assessment of the GREFS at 2 years after HSCT, a composite endpoint defined as the probability of survival without severe GVHD, relapse/progression of the hematological malignancy, or PTCy-associated adverse event, whichever comes first from transplantation
Endpoint(s): Overall survival (OS) at 2 years: From transplantation until death from any cause or up to 24 months, whichever occurs first, Quality of life at 1, 3, 6, 12, and 24 months after HSCT compared to baseline using two questionnaires: FACT-BMT (Functional Assessment of Cancer Therapy - Bone Marrow Transplant, version 4) and EQ-5D-5L (EuroQol 5-Dimension, 5-Level questionnaire)., Organ damage toxicities assessed by the common terminology criteria for adverse events (CTCAE) v5.0, cumulative incidences of bacterial, viral, and fungal infections, and failure to achieve neutrophil recovery (absolute neutrophil count > 0.5 x 109/L) or platelet recovery (platelet count > 50 x 109/L) after HSCT From transplantation until the occurrence of the event, day +60 for hematological recovery, or up to 24 months for organ damage toxicities and infections, whichever occurs first, Cumulative incidence and severity of acute and chronic GVHD: From transplantation until the occurrence of GVHD or death from any cause, or up to 180 days after transplantation for acute GVHD, or up to 24 months for chronic GVHD, whichever occurs first, Non-relapse mortality (NRM) at 2 years: From transplantation until death without evidence of relapse or up to 24 months, whichever occurs first, Cumulative incidence of relapse at 2 years: From transplantation until the occurrence of relapse or up to 24 months, whichever occurs first, Disease-free survival (DFS) at 2 years: From transplantation until relapse or progression of the hematological disease, death, or up to 24 months, whichever occurs first, GVHD-free, relapse-free survival (GRFS) at 2 years: From transplantation until the occurrence of acute grade III-IV GVHD, severe chronic GVHD, relapse, death, or up to 24 months, whichever occurs first, Incremental cost-effectiveness (cost/life year) and cost-utility (cost/quality-adjusted life-year, QALY) ratios at 2 years.

Source: https://euclinicaltrials.eu/ctis-public/view/2024-519986-23-00